EU clinical trial 2023-508083-30-00: A Phase II, Randomized, Blinded, Placebo-Controlled Study of Tiragolumab, an Anti- TIGIT Antibody, in Combination with Atezolizumab in Chemotherapy-Naive Patients with Locally Advanced or Metastatic Non-Small Cell Lung Cancer
Protocol code: GO40290
Sponsor: Genentech Inc. (Pharmaceutical company). Phase: Therapeutic exploratory (Phase II). Countries: Spain (ended), France (ended).
Therapeutic area(s): Diseases [C] - Neoplasms [C04]
Gender: Female, Male. Age: 18-64 years, 65+ years. Enrolment: 47.
Status: Ended. Start date (EU): 2018-07-19. End date (EU): 2025-07-08. End date: 2025-11-14. Decision date: 2024-05-06. Results received: Yes. Last updated: 2025-05-26.
Decision dates by country: ES: 2024-05-06, FR: 2024-05-14

Condition(s): Non-small cell lung cancer (NSCLC)
Product: Tecentriq 1 200 mg concentrate for solution for infusion, Tiragolumab Placebo, Tiragolumab

Primary endpoint: 1. ORR as determined by the investigator according to RECIST v1.1, 2. PFS as determined by the investigator according to RECIST v1.1, or death from any cause, whichever occurs first
Endpoint(s): 1. DOR as determined by the investigator according to RECIST v1.1, or death from any cause, whichever occurs first, 2. Overall survival, 3. Incidence, nature, and severity of adverse events, graded according to the NCI CTCAE v4.0, 4. Clinically significant changes from baseline in vital signs, physical findings, and clinical laboratory results, 5. Serum concentrations of tiragolumab or atezolizumab at specified timepoints, 6. Incidence of treatment-emergent Anti-drug antibodies (ADAs) and their potential impact on safety, efficacy, and pharmacokinetics

Source: https://euclinicaltrials.eu/ctis-public/view/2023-508083-30-00